EU clinical trial 2024-512075-12-00: C3731003 Phase 3, Open-Label, Single-Arm Study to Evaluate the Efficacy and Safety of PF-07055480 (Recombinant AAV2/6 Human Factor VIII Gene Therapy) in Adult Male Participants with Moderately Severe to Severe Hemophilia A (FVIII:C≤1%)
Protocol code: C3731003
Sponsor: Pfizer Inc. (Pharmaceutical company). Phase: Therapeutic confirmatory (Phase III). Countries: Germany (ongoing, recruitment ended), Spain (ongoing, recruitment ended), France (ongoing, recruitment ended), Greece (ongoing, recruitment ended), Sweden (ongoing, recruitment ended).
Therapeutic area(s): Diseases [C] - Hemic and Lymphatic Diseases [C15]
Gender: Male. Age: 18-64 years. Enrolment: 18.
Status: Ongoing, recruitment ended. Start date (EU): 2021-06-14. Decision date: 2024-06-13. Results received: No. Last updated: 2026-06-26.
Decision dates by country: FR: 2024-07-02, GR: 2024-08-28, SE: 2024-06-18, DE: 2024-06-14, ES: 2024-06-13

Condition(s): hemophilia A
Product: giroctocogene fitelparvovec

Primary endpoint: Total annualized bleeding rate (ABR, spontaneous and traumatic bleedings, treated and untreated) from Week 12 through at least 15 months following PF-07055480 infusion versus Total ABR on prior Factor VIII (FVIII) prophylaxis replacement regimen.
Endpoint(s): Factor VIII (FVIII) activity level >5% at 15 months following infusion of PF-07055480., ABR (spontaneous and traumatic treated bleedings) from Week 12 through at least 15 months following PF-07055480 infusion versus ABR on prior FVIII prophylaxis replacement regimen., Annualized infusion rate (AIR) of exogenous FVIII from Week 12 through at least 15 months following infusion of PF-07055480 versus AIR on prior FVIII prophylaxis replacement regimen., FVIII activity level from Week 12 through 15 months following infusion of PF-07055480., The following secondary parameters will be assessed from Week 12 through at least 15 months after PF-07055480 infusion and compared with prior FVIII prophylaxis replacement regimen: • Annualized FVIII consumption. • Annualized bleeding rate (ABR) of specific type: o by cause (spontaneous or traumatic) o by location (in joints, in target joints, or in soft tissue). • Total ABR by cause and by location. • Percentage of participants without bleeds., The following secondary parameters will be assessed by visit after PF- 07055480 infusion: • FVIII activity level. • Change from baseline in joint health as measured by the HJHS instrument. • Change from baseline in the following patient-reported outcome (PRO) endpoints: o Haemophilia Quality of Life Questionnaire for Adults (Haem-AQoL) o Haemophilia Activities List (HAL)., The following parameters will be analysed yearly or by visit as appropriate: • ABR. • FVIII activity level. • AIR of exogenous FVIII. • Annualized FVIII consumption. • ABR of specific type: o by cause (spontaneous or traumatic). o by location (in joint, in target joints, or in soft tissue). • Total ABR. • Total ABR by cause and by location. • Percentage of participants without bleeds., The following parameters will be analysed yearly or by visit as appropriate: • Change from baseline in joint health as measured by the HJHS instrument. • Change from baseline in PRO endpoints: Haem-A-QoL and HAL. In addition, ABR, Total ABR, and AIR will be analyzed throughout the 5 year study period., - Incidence and severity of adverse events (AEs). - Events of special interest (such as hypersensitivity reactions, clinically reported thrombotic events, and malignancy)., - Immunogenicity: • Antibodies against adeno-associated virus 6 (AAV6) capsid protein (neutralizing antibodies [nAbs] and anti-drug antibodies [ADAs]). • T-cell responses against AAV6 capsid and against the transgene. • FVIII inhibitors.

Source: https://euclinicaltrials.eu/ctis-public/view/2024-512075-12-00